EU clinical trial 2024-516099-13-00: ICEBOAT. A prospective, multi-center, double blind randomized trial of fecal microbiota transplantation (FMT) delivered by capsule versus placebo in severe irritable bowel syndrome (IBS)
Protocol code: APHP180583
Sponsor: Assistance Publique Hopitaux De Paris (Hospital/Clinic/Other health care facility). Phase: Therapeutic confirmatory (Phase III). Countries: France (ongoing, recruiting).
Therapeutic area(s): Diseases [C] - Digestive System Diseases [C06]
Gender: Female, Male. Age: 18-64 years, 65+ years. Enrolment: 150.
Status: Ongoing, recruiting. Start date (EU): 2025-09-25. Decision date: 2024-10-23. Results received: No. Last updated: 2025-05-21.

Condition(s): Severe Irritable Bowel Syndrome (IBS)
Product: Double encapsulated oral transplant of fecal microbiota, Placebo double encapsulated oral transplant of fecal microbiota

Primary endpoint: Decrease in IBS severity at 12 weeks is defined by the percentage of patients having at least a 75 points decrease in IBS-SSS
Endpoint(s): Decrease in IBS severity at 12 weeks defined by the percentage of patients having at least a 50 points decrease in IBS-SSS., FMT success : The composition of the patient’s fecal microbiota 12 weeks after FMT will be compared to the patient’s microbiota before transplantation and to the donor using the Sorensen similarity index. The FMT will be considered as a success if the Sorensen index [patient after FMT vs donor] > Sorensen index [patient after FMT vs patient before FMT] and if the Sorensen index [patient after FMT vs donor] ≥ 0,6. The composition of fecal microbiota will be measured by pyrosequencing (16S RNA)., Intestinal microbiota composition and diversity at week 12 and 24 assessed by 16s sequencing. Microbiota composition and diversity assessed by 16s sequencing at week 12 and 24, compared to baseline and to healthy volunteers donor’s microbiota. Microbiota composition will be assessed using Qiime pipeline and analyzed at all phylogenetic levels. Diversity will be evaluated using Shannon index, Simpson index, Chao1 index and number of observed species, Efficacy at week 24 according to FMT success : decrease in IBS severity >75 points, EMA Endpoint at week 12 and 24 defined as a patient who fulfils the response criteria (simultaneous improvement of transit and abdominal pain) displayed in the following for at least 50% of the observation time, Percentage of responders in the different subgroups IBS-D, IBS-C and IBS-M using the primary endpoint at week 12 and 24., Mean IBS-SSS (IBS severity), comparison between FMT and placebo at 12 and 24 weeks), Mean IBS-QoL score (IBS Quality of life) comparison between FMT and placebo at 12 and 24 weeks (Drossman et al. 2000), Patient’s perception of FMT : 1/Questionnaire for correct assessment of FMT or placebo and FMT acceptability at V2 (FMT administration) (Annex D). 2/ Questionnaire for assessment of FMT secondary effects à V3 (Annex E), Safety (Serious Adverse Events, Adverse Events) compared between groups

Source: https://euclinicaltrials.eu/ctis-public/view/2024-516099-13-00